EU clinical trial 2024-512314-17-00: FINISHER – Fight INflammation to Improve outcome after aneurysmal Subarachnoid HEmorRhage
Protocol code: NCH-201803
Sponsor: Rheinische Friedrich-Wilhelms-Universitaet Bonn (Educational Institution). Phase: Therapeutic confirmatory (Phase III). Countries: Germany (ended).
Therapeutic area(s): Diseases [C] - Nervous System Diseases [C10]; Diseases [C] - Neoplasms [C04]
Gender: Female, Male. Age: 18-64 years, 65+ years. Enrolment: 334.
Status: Ended. Start date (EU): 2021-11-24. End date (EU): 2025-09-09. Decision date: 2024-05-31. Results received: No. Last updated: 2024-05-31.

Condition(s): Aneurysmal Subarachnoid Hemorrhage (SAH)
Product: placebo to match Dexa 8 mg inject JENAPHARM® name of manufacturer: mibe, Dexa 8 mg inject JENAPHARM Injektionslösung

Primary endpoint: Comparison of combined mortality and severe disability between study arms, assessed by the modified Rankin Scale (mRS) 6 months after the subarachnoid hemorrhage - dichotomized in “favourable (mRS 0-3) versus “unfavourable“ (mRS 4-6) outcome.
Endpoint(s): a) Analysis of mortality at 7, 90 and 365 days after aSAH b) Comparison of time of death in patients, Length of ICU stay and hospitalization after aSAH, Delayed ischemic neurological deficit (DIND), Symptomatic vasospasm measured by transcranial doppler / computed tomography scans / MR angiography / angiography, Level of inflammation parameters such as CRP, PCT, WBC, IL-6 in serum, Analysis of SF36 scores and EQ-ED scores in patients on discharge and at 90, 180 and 365 days after aSAH, Analysis of AEs by number, severity, relationship

Source: https://euclinicaltrials.eu/ctis-public/view/2024-512314-17-00